EU clinical trial 2023-506146-23-00: Phase 2b Clinical Study Evaluating Efficacy and Safety of TAR-200 in Combination with Cetrelimab, TAR-200 Alone, or Cetrelimab Alone in Participants with High-Risk Non- Muscle Invasive Bladder Cancer (NMIBC) Unresponsive to Intravesical Bacillus Calmette- Guérin (BCG) who are Ineligible for or Elected Not to Undergo Radical Cystectomy
Protocol code: 17000139BLC2001
Sponsor: Janssen - Cilag International (Pharmaceutical company). Phase: Therapeutic exploratory (Phase II). Countries: Germany (ongoing, recruitment ended), France (ongoing, recruitment ended), Netherlands (ongoing, recruitment ended), Portugal (ongoing, recruitment ended), Spain (ongoing, recruitment ended), Belgium (ongoing, recruitment ended), Greece (ongoing, recruitment ended), Italy (ongoing, recruitment ended).
Therapeutic area(s): Diseases [C] - Neoplasms [C04]
Gender: Female, Male. Age: 18-64 years, 65+ years. Enrolment: 130.
Status: Ongoing, recruitment ended. Start date (EU): 2025-11-17. Decision date: 2024-05-13. Results received: No. Last updated: 2026-07-31.
Decision dates by country: FR: 2024-05-28, BE: 2024-05-17, ES: 2024-05-17, NL: 2024-05-16, GR: 2024-06-21, DE: 2024-05-16, PT: 2024-05-13, IT: 2024-06-24

Condition(s): Non-Muscle-Invasive Urothelial Carcinoma (NMIBC) of the Bladder
Product: JNJ-17000139, JNJ-63723283, JNJ-63723283

Primary endpoint: Overall CR rate will be measured by determining the proportion of participants without presence of high-grade disease using results from cystoscopy and centrally read urine cytology at any timepoint, Cohort 4 only: DFS will be measured as the time from the date of first dose of study treatment to either the time of the first recurrence of highrisk disease, progression, or death due to any cause, whichever occurs first.
Endpoint(s): DOR is defined as the date of first CR achieved to the date of first evidence of recurrence or progression or death, using cystoscopy, centrally read bladder biopsy and urine cytology, and imaging, if available. Twelve month DOR will be determined, OS, defined as the time from the date of first dose of study treatment to death; if a participant has not died at the time of analysis, the participant will be censored at the date last known alive, Gemcitabine and dFdU concentrations in urine and plasma, Serum concentration and incidence of anti-cetrelimab antibodies, Change from baseline and time to symptom deterioration in EORTC QLQ-C30 and EORTC QLQ-NMIBC24, Frequency and grade of adverse events (AEs) (according to Common Terminology Criteria for Adverse Events [CTCAE] version 5), Laboratory abnormalities: CTCAE grades comparing baseline to the worst post-baseline value; other safety data, such as vital signs, will be considered as appropriate

Source: https://euclinicaltrials.eu/ctis-public/view/2023-506146-23-00